EU clinical trial 2024-510720-38-00: A phase IIa multicentre randomized controlled double blind clinical trial to demonstrate clinical efficacy on cognitive, neuropsychiatric and functional outcomes of Ambroxol in New and Early patients with prodromal and mild Dementia with Lewybodies (The ANeED study)
Protocol code: 2019-002855-41
Sponsor: Helse Fonna HF (Hospital/Clinic/Other health care facility). Phase: Therapeutic exploratory (Phase II). Countries: Norway (ongoing, recruiting).
Therapeutic area(s): Diseases [C] - Nervous System Diseases [C10]; Psychiatry and Psychology [F] - Mental Disorders [F03]
Gender: Female, Male. Age: 18-64 years, 65+ years. Enrolment: 156.
Status: Ongoing, recruiting. Start date (EU): 2021-01-12. Decision date: 2024-10-22. Results received: No. Last updated: 2026-04-16.

Condition(s): Dementia with Lewy Bodies
Product: Placebo matching active treatment., Ambroxol

Primary endpoint: Mean score on the MMSE at screening to 18 months in the intervention group compared to the control group.
Endpoint(s): Mean score in MMSE at 18 months in the ambroxol group compared to the placebo group in subgroups defined by APOE and GBA genotypes and A-Beta in CSF., Mean score at 18 months between the ambroxol group compared to the placebo group for the clock drawing test, COWAT immediate and delayed recall, Trail making test A&B, VOSP siluettes and FAS test., Mean score in the Clinician’s Global Impression of Change (ADCS-CGIC) score at Month 18 in the ambroxol and placebo groups., Mean score in the total NPI score at Month 18 in the ambroxol group compared to the placebo group., Mean score on the UPDRS-part III motor part and the MAYO fluctuation scores at month 18, The number of participants with RBD defined from the Mayo Sleep Questionnaire at month 18 in ambroxol and placebo groups., The number of falls at month 18 in the ambroxol and in the placebo groups.

Source: https://euclinicaltrials.eu/ctis-public/view/2024-510720-38-00